EU clinical trial 2025-523497-16-00: TSRA196-AAT-201: A Phase 1/2, Open-Label, Multi-Center, Dose Escalation, Dose Expansion, and Single Repeat Dose Study of TSRA-196 in Adults With the PiZZ Genotype Who Have Lung and/or Liver Disease Associated with Severe Alpha-1 Antitrypsin Deficiency
Protocol code: TSRA196-AAT-201
Sponsor: Tessera Therapeutics Inc. (Pharmaceutical company). Phase: Phase I and Phase II (Integrated)- First administration to humans. Countries: Ireland (authorised, recruitment pending), Sweden (authorised, recruitment pending), Netherlands (authorised, recruitment pending).
Therapeutic area(s): Diseases [C] - Respiratory Tract Diseases [C08]; Diseases [C] - Congenital, Hereditary, and Neonatal Diseases and Abnormalities [C16]; Diseases [C] - Nutritional and Metabolic Diseases [C18]
Gender: Female, Male. Age: 18-64 years, 65+ years. Enrolment: 25.
Status: Authorised, recruitment pending. Decision date: 2026-06-08. Results received: No. Last updated: 2026-06-15.
Decision dates by country: IE: 2026-06-12, SE: 2026-06-08, NL: 2026-06-15

Condition(s): Lung and/or Liver Disease Associated with Alpha-1 Antitrypsin Deficiency (AATD)
Product: TSRA-196

Primary endpoint: Part 1: Incidence of TEAEs and SAEs Part 2: Proportion of participants who have serum levels of total AAT ≥LLN at Month 3 and Month 6 after TSRA-196 treatment Part 3: Proportion of participants who have serum levels of total AAT ≥LLN at Month 3 and Month 6 after a second dose of TSRA-196 Part 2 and 3: Change from baseline in functional AAT concentrations (determined using an elastase inhibition assay) to Month 12
Endpoint(s): Part 1: Proportion of participants who have serum levels of total AAT ≥LLN: • at Month 3 and Month 6 after TSRA-196 treatment • from Month 6 through Month 12 after TSRA-196 treatment • from Month 3 through Month 12 after TSRA-196 treatment, Part 1: Proportion of participants who have serum levels of total AAT ≥11 μM: • at Month 3 and Month 6 after TSRA-196 treatment • from Month 6 through Month 12 after TSRA-196 treatment • from Month 3 through Month 12 after TSRA-196 treatment, Part 1 and 2 and 3: Change in serum levels of total AAT from baseline over time, Part 1 and 2 and 3: Incidence of AESI from day of dosing through EOS/ET, Part 1 and 2 and 3: Change in clinical laboratory parameters, vital signs, and ECG parameters over time, Part 1 and 2 and 3: PK parameters for • ionizable lipid in blood • DMG-PEG2000 in blood • mRNA in blood • tgRNA in blood, Part 2 and 3: Incidence of TEAEs and SAEs, Part2: Proportion of participants who have serum levels of total AAT ≥LLN • from Month 6 through Month 12 after TSRA-196 treatment • from Month 3 through Month 12 after TSRA-196 treatment, Part 2: Proportion of participants who have serum levels of total AAT ≥11 μM: • at Month 3 and Month 6 after TSRA-196 treatment • from Month 6 through Month 12 after TSRA-196 treatment • from Month 3 through Month 12 after TSRA-196 treatment, Part 3: Proportion of participants who have serum levels of total AAT ≥LLN: • from Month 6 through Month 12 after a second dose of TSRA-196 • from Month 3 through Month 12 after a second dose of TSRA-196, Part 3: Proportion of participants who have serum levels of total AAT ≥11 μM: • at Month 3 and Month 6 after a second dose of TSRA-196 • from Month 6 through Month 12 after a second dose of TSRA-196 • from Month 3 through Month 12 after a second dose of TSRA-196, Part 2 and 3: Change from baseline in functional AAT concentrations (determined using an elastase inhibition assay) to Month 3 and to Month 6, Part 2 and 3: Change from baseline in post-bronchodilator ppFEV1 through Month 12, Part 2 and 3: Incidence of COPD exacerbations from baseline over time

Source: https://euclinicaltrials.eu/ctis-public/view/2025-523497-16-00